EU clinical trial 2025-523523-21-00: C6461006 - An Interventional Phase 1b/2, Open-Label Study to Investigate the Safety, Antitumor Activity, and Pharmacokinetics of PF-08634404 Monotherapy or in Combination With Enfortumab Vedotin in Adult Participants With Locally Advanced or Metastatic Urothelial Cancer.
Protocol code: C6461006
Sponsor: Pfizer Inc. (Pharmaceutical company). Phase: Phase I and Phase II (Integrated)- Other. Countries: Netherlands (authorised, recruitment pending), Spain (ongoing, recruiting).
Therapeutic area(s): Diseases [C] - Neoplasms [C04]
Gender: Female, Male. Age: 18-64 years, 65+ years. Enrolment: 36.
Start date (EU): 2026-07-03. Decision date: 2026-05-29. Results received: No. Last updated: 2026-06-24.
Decision dates by country: ES: 2026-06-01, NL: 2026-05-29

Condition(s): Locally Advanced or Metastatic Urothelial Cancer
Product: Padcev 30 mg powder for concentrate for solution for infusion, PF-08634404

Primary endpoint: Cohort A: Confirmed ORR by investigator, AEs as characterized by type, frequency, severity (as graded by NCI CTCAE version 5.0), timing, seriousness and relationship to study intervention, Cohort B: DLTs during the DLT-observation period (Cycle 1) (Part 1), AEs as characterized by type, frequency, severity (as graded by NCI CTCAE version 5.0), timing, seriousness and relationship to study intervention(s), Confirmed ORR by investigator
Endpoint(s): DoR by investigator, PFS by investigator, OS, Laboratory abnormalities as characterized by type, frequency, severity (as graded by NCI CTCAE version 5.0), Predose and postdose concentrations of PF-08634404, Incidence of ADA against PF-08634404

Source: https://euclinicaltrials.eu/ctis-public/view/2025-523523-21-00